EU clinical trial 2024-510641-33-00: A randomized, double-blind, placebo-controlled, parallel-group, dose ranging study to assess the efficacy, safety, and tolerability of subcutaneous amlitelimab in adult participants with moderate-to-severe asthma. DRI17509
Protocol code: DRI17509
Sponsor: Sanofi-Aventis Recherche & Developpement (Pharmaceutical company). Phase: Therapeutic exploratory (Phase II). Countries: Italy (ended), Hungary (ended), Poland (ended).
Therapeutic area(s): Diseases [C] - Respiratory Tract Diseases [C08]
Gender: Female, Male. Age: 18-64 years, 65+ years. Enrolment: 104.
Status: Ended. Start date (EU): 2023-01-17. End date (EU): 2025-03-20. End date: 2025-03-21. Decision date: 2024-05-08. Results received: Yes. Last updated: 2024-10-07.
Decision dates by country: IT: 2024-05-08, HU: 2024-05-08, PL: 2024-05-09

Condition(s): Asthma
Product: Amlitelimab, Placebo

Primary endpoint: Annualized rate of severe exacerbation events over 48 weeks
Endpoint(s): Change from baseline in pre-bronchodilator (BD) FEV1 at Week 48, Change from baseline in Asthma Control Questionnaire 5 (ACQ-5) score at Week 48, Change from baseline in Asthma Quality of Life Questionnaire with Standardized Activities (AQLQ (S)) Self-Administered Score at Week 48, Change from baseline in post-BD FEV1 at Week 48, The absolute change in the percent predicted FEV1 from baseline to Week 48 (pre-BD and post-BD), Change from baseline in ACQ-5 score at Weeks 2, 4, 8, 12, 24, 36, and 60, Time to first severe exacerbation event, Change from baseline in pre-BD and post-BD FEV1, Change from baseline in peak expiratory flow (PEF) and forced expiratory flow (FEF) 25-75%, Change from baseline in forced vital capacity (FVC), Change from baseline in FeNO at Weeks 2, 4, 8, 12, 16, 24, 36, 48 and 60, Annualized rate of loss of asthma control (LOAC) events during 48 weeks of treatment, Time to first LOAC event, Change from baseline in the Asthma Daytime Symptom Diary (ADSD) 6-item daily morning score and in the Asthma Nighttime Symptom Diary (ANSD) 6-item daily evening scores at Weeks 2, 4, 8, 12, 24, 36, 48, and 60, Annualized rate of severe asthma exacerbations requiring hospitalization or emergency room or urgent care visit during 48 weeks of treatment, Change from baseline in the numbers of inhalations/day of SABA or low-dose ICS/formoterol for symptom relief at Weeks 2, 4, 8, 12, 24, 36, 48, and 60, Serum amlitelimab concentrations measured throughout the study, Incidence of anti-amlitelimab antibody positive response, Percentage of participants with treatment-emergent adverse events (TEAEs), including local reactions, AEs of special interest (AESIs), serious adverse events (SAEs), Incidence of potentially clinically significant laboratory test, vital signs, and ECG abnormalities in the treatment period, Change from baseline in Asthma Quality of Life Questionnaire with Standardized Activities (AQLQ (S)) Self-Administered Score at Weeks 2, 4, 8, 12, 24, 36, and 60, Change from baseline in St. George’s Respiratory Questionnaire (SGRQ) at Weeks 2, 4, 8, 12, 24, 36, 48, and 60, Proportion of participants with a decrease from baseline of at least 4 points in SGRQ total score at Week 48, Change from baseline in ACQ-6 score and ACQ-7 at Weeks 2, 4, 8, 12, 24, 36, 48, and 60

Source: https://euclinicaltrials.eu/ctis-public/view/2024-510641-33-00